EU clinical trial 2023-508426-10-00: A Phase 1 Randomized, Open Label Pharmacokinetic Comparability Study Comparing Pre- and Post-change Teclistamab in Participants with Relapsed/Refractory Multiple Myeloma
Protocol code: 64007957MMY1008
Sponsor: Janssen Cilag International (Pharmaceutical company). Phase: Human Pharmacology (Phase I)- Other. Countries: Poland (ongoing, recruitment ended), Spain (ongoing, recruitment ended), France (ongoing, recruitment ended), Italy (ongoing, recruitment ended), Germany (ongoing, recruitment ended).
Therapeutic area(s): Diseases [C] - Hemic and Lymphatic Diseases [C15]
Gender: Female, Male. Age: 18-64 years, 65+ years. Enrolment: 48.
Status: Ongoing, recruitment ended. Start date (EU): 2024-06-03. Decision date: 2024-06-03. Results received: No. Last updated: 2026-02-08.
Decision dates by country: ES: 2024-06-10, FR: 2024-06-03, DE: 2024-06-04, PL: 2024-06-10, IT: 2024-06-05

Condition(s): Relapsed/Refractory Multiple Myeloma

Source: https://euclinicaltrials.eu/ctis-public/view/2023-508426-10-00